EU clinical trial 2024-519383-40-00: Assessing Oxytocin's Role in Mitigating Psychosocial Stress in Breast Cancer Survivors
Sponsor: UZ Leuven (Hospital/Clinic/Other health care facility). Phase: Therapeutic confirmatory (Phase III). Countries: Belgium (authorised, recruitment pending).
Therapeutic area(s): Phenomena and Processes [G] - Physiological processes [G07]
Gender: Female. Age: 18-64 years, 65+ years. Enrolment: 60.
Status: Authorised, recruitment pending. Decision date: 2025-08-19. Results received: No. Last updated: 2025-08-19.

Condition(s): breast cancer
Product: Placebo - Physiological water-based nasal sprays (NaCl 0.9%), Oxytocine CD Pharma 40 IE/ml neusspray, oplossing

Primary endpoint: Assessments of self-perceived emotional stress, using the Dutch versions of the self-report Perceived stress scale (PSS) and the Depression Anxiety Stress Scale (DASS-42)
Endpoint(s): Assessments of the following self-report questionnaires will be acquired as secondary end points: Cognitive Failure Questionnaire (CFQ), Checklist Individual Strength (CIS), Quality of Life (WHO-5), State Adult Attachment Measure (SAAM), Pittsburg Sleep quality index (PSQI), Perseverative Thinking Questionnaire (PTQ), and self-rated imression of severity and improvement (CGI)., Objective cognitive performance will be measured with the the digital Amsterdam Cognition Scan (ACS).

Source: https://euclinicaltrials.eu/ctis-public/view/2024-519383-40-00